EU clinical trial 2024-518275-64-00: A phase II efficacy and safety study of cell-free circulating tumor DNA-guided commencement of second-line treatment in patients with DLBCL/HGBCL relapse
Protocol code: IHIT/2021/1
Sponsor: Instytut Hematologii I Transfuzjologii (Laboratory/Research/Testing facility). Phase: Therapeutic exploratory (Phase II). Countries: Poland (authorised, recruitment pending).
Therapeutic area(s): Diseases [C] - Neoplasms [C04]
Gender: Female, Male. Age: 18-64 years, 65+ years. Enrolment: 340.
Status: Authorised, recruitment pending. Decision date: 2024-12-02. Results received: No. Last updated: 2025-11-24.

Condition(s): Diffuse large B-cell lymphomas (DLBCL, Diffuse large B-cell lymphoma) and aggressive B-cell lymphomas (HGBCL, High-grade B-cell lymphoma) originate from mature B-cells at various stages of terminal differentiation
Product: Revlimid 10 mg hard capsules, Revlimid 20 mg hard capsules, Bendamustine Glenmark, 2,5 mg/ml, proszek do sporządzania koncentratu roztworu do infuzji, Revlimid 7.5 mg hard capsules, Revlimid 15 mg hard capsules, Revlimid 25 mg hard capsules, YESCARTA 0.4 – 2 x 10e8 cells dispersion for infusion, Revlimid 2.5 mg hard capsules, Polivy 30 mg powder for concentrate for solution for infusion., ALEXAN, 20 MG/ML, ROZTWÓR DO WSTRZYKIWAŃ, Riximyo 500 mg concentrate for solution for infusion, Revlimid 5 mg hard capsules, MINJUVI 200 mg powder for concentrate for solution for infusion, ALEXAN, 50 MG/ML, ROZTWÓR DO INFUZJI, Riximyo 100 mg concentrate for solution for infusion, Cisplatin Ebewe 1 mg/ml infuusiokonsentraatti, liuosta varten, Dexamethasone Krka, 40 mg, tabletki, Polivy 140 mg powder for concentrate for solution for infusion., Dexamethasone Krka, 20 mg, tabletki

Primary endpoint: ORR for second-line treatment initiated based on a diagnostic algorithm that takes into account cfDNA levels., The incidence of grade 3 and 4 adverse reactions assessed according to CTCAE v. 5.
Endpoint(s): Assessment of health-related quality of life using the EORTC QLQ-C30 generic questionnaire., Sensitivity, specificity, PPV, NPV of circulating DNA assay measured by NGS and/or ddPCR (individually selected markers) after first-line treatment in relation to the likelihood of maintaining CR status at 36 months of follow-up, TTNT since the end of first-line treatment, which will be referenced to archival/historical groups of patients treated at hematology centers collaborating in the PLRG

Source: https://euclinicaltrials.eu/ctis-public/view/2024-518275-64-00